EU clinical trial 2024-514465-18-00: An Open-label Multi-Cohort Phase 1b/2 Study to Evaluate the Safety, Efficacy, and Optimal Dose of Telisotuzumab Adizutecan in Combination with a PD-1 Immune Checkpoint Inhibitor in Advanced or Metastatic Non-Squamous NSCLC with No Prior Treatment for Advanced Disease and No Actionable Genomic Alterations (AndroMETa Lung 536)
Protocol code: M24-536
Sponsor: AbbVie Deutschland GmbH & Co. KG (Pharmaceutical company). Phase: Phase I and Phase II (Integrated)- Other. Countries: Romania (ongoing, recruiting), Germany (ongoing, recruiting), Spain (ongoing, recruiting), Belgium (ongoing, recruiting), France (ongoing, recruiting), Italy (authorised, recruiting), Poland (ongoing, recruiting).
Therapeutic area(s): Analytical, Diagnostic and Therapeutic Techniques and Equipment [E] - Therapeutics [E02]; Diseases [C] - Neoplasms [C04]
Gender: Female, Male. Age: 18-64 years, 65+ years. Enrolment: 96.
Start date (EU): 2025-04-23. Decision date: 2025-04-07. Results received: No. Last updated: 2026-06-15.
Decision dates by country: DE: 2025-04-10, IT: 2025-04-07, RO: 2025-04-15, PL: 2025-04-14, BE: 2025-04-07, ES: 2025-04-08, FR: 2025-04-07

Condition(s): Advanced or Metastatic Non-Squamous NSCLC
Product: Cisplatin 1mg/ml Injection BP, Budigalimab, KEYTRUDA 25 mg/mL concentrate for solution for infusion, Telisotuzumab adizutecan, Carboplatin 10 mg/ml Intravenous Infusion, ALIMTA 500 mg powder for concentrate for solution for infusion

Primary endpoint: Part 1: dose-limiting toxicity., Part 2: efficacy endpoint is the OR as assessed by BICR (as confirmed CR or PR based on RECIST v1.1).
Endpoint(s): Progression Free Survival (PFS): the time from the subject's randomization date to the first occurrence of radiographic progression per BICR based on RECIST v1.1 or death from any cause, whichever occurs earlier., Duration Of Response (DOR): the time from the first documented CR or PR per BICR to the first occurrence of radiographic progression per RECIST v1.1 or death from any cause, whichever occurs first., Disease Control: best overall response of confirmed CR or confirmed PR, or SD for at least 11 weeks following randomization date based on RECIST v1.1, by the BICR. OR, PFS, DOR, and DC by investigator per RECIST v1.1., Overall Survival: the time from subject's randomization date (Part 2) or first dose date of study treatment (Part 1) to the event of death from any cause. Subjects with no documented death will be censored at the last known alive date., OR, PFS, OS, DOR, and DC in PD-L1 and c-Met subgroups.

Source: https://euclinicaltrials.eu/ctis-public/view/2024-514465-18-00